EU clinical trial 2023-508960-31-00: A Phase 3, randomized, open-label, multicenter, controlled study to evaluate the efficacy and safety of zanidatamab in combination with physician’s choice chemotherapy compared to trastuzumab in combination with physician’s choice chemotherapy for the treatment of participants with metastatic HER2-positive breast cancer who have progressed on, or are intolerant to, previous trastuzumab deruxtecan treatment
Protocol code: JZP598-303
Sponsor: Jazz Pharmaceuticals Ireland Limited (Pharmaceutical company). Phase: Therapeutic confirmatory (Phase III). Countries: Belgium (ongoing, recruiting), France (ongoing, recruiting), Spain (ongoing, recruiting), Italy (ongoing, recruiting), Germany (ongoing, recruiting), Austria (ongoing, recruiting), Greece (ongoing, recruiting), Poland (ongoing, recruiting).
Therapeutic area(s): Diseases [C] - Neoplasms [C04]
Gender: Female, Male. Age: 18-64 years, 65+ years. Enrolment: 264.
Status: Ongoing, recruiting. Start date (EU): 2024-12-03. Decision date: 2024-11-19. Results received: No. Last updated: 2026-06-17.
Decision dates by country: IT: 2024-11-21, DE: 2024-11-20, PL: 2024-11-24, GR: 2024-11-22, ES: 2024-11-20, BE: 2024-11-25, AT: 2024-11-25, FR: 2024-11-19

Condition(s): Metastatic HER2-positive breast cancer
Product: VINORELBINE, CAPECITABINE, TRASTUZUMAB, JZP598, ERIBULIN, GEMCITABINE

Primary endpoint: Progression-free survival per RECIST version 1.1, assessed by BICR
Endpoint(s): Overall survival, Confirmed ORR per RECIST version 1.1, assessed by BICR, DOR per RECIST version 1.1, assessed by BICR, PFS per RECIST version 1.1, assessed by investigator, Confirmed ORR per RECIST version 1.1, assessed by investigator, DOR per RECIST version 1.1, assessed by investigator, Frequency of TEAEs and SAEs as graded by NCI CTCAE version 5.0, Frequency of dose reductions, Frequency of discontinuations of treatment due to TEAEs, Serum concentrations of zanidatamab as a function of time postdosing, Frequency, duration, and time of onset of anti-zanidatamab antibodies and neutralizing antibodies, if applicable, Descriptive summary of the proportion of all treated patients, as treated, reporting symptomatic AEs while on treatment based on the PRO‑CTCAE and EORTC Item Library, Descriptive summary of the proportion of all treated patients, as treated, reporting overall side-effect bother on the FACIT-GP5, The proportion of treated patients, as treated, with maintained or improved physical function while on treatment based on the physical functioning subscale of the EORTC QLQ-C30, The proportion of treated patients, as treated, with maintained or improved role function while on treatment based on the role functioning subscale of the EORTC QLQ-C30, Change from baseline and time to worsening of select scores from the EORTC QLQC30, EORTC IL341, and PGI-S

Source: https://euclinicaltrials.eu/ctis-public/view/2023-508960-31-00